EU clinical trial 2023-503675-24-00: A Phase III, Open-label, Randomised Study of Datopotamab Deruxtecan (Dato-DXd) With or Without Durvalumab Compared with Investigator’s Choice of Chemotherapy (Paclitaxel, Nab-paclitaxel or Gemcitabine + Carboplatin) in Combination With Pembrolizumab in Patients with PD-L1 Positive Locally Recurrent Inoperable or Metastatic Triple-negative Breast Cancer
Protocol code: Tropion-Breast05
Sponsor: AstraZeneca AB (Pharmaceutical company). Phase: Therapeutic confirmatory (Phase III). Countries: Spain (ongoing, recruiting), France (ongoing, recruiting), Italy (ongoing, recruiting), Poland (ongoing, recruiting).
Therapeutic area(s): Diseases [C] - Neoplasms [C04]
Gender: Female, Male. Age: 18-64 years, 65+ years. Enrolment: 40.
Status: Ongoing, recruiting. Start date (EU): 2025-01-17. Decision date: 2024-11-28. Results received: No. Last updated: 2026-04-23.
Decision dates by country: IT: 2024-12-02, FR: 2024-12-06, ES: 2024-11-28, PL: 2025-10-17

Condition(s): Triple-negative Breast Cancer
Product: PEMBROLIZUMAB, IMFINZI 50 mg/mL concentrate for solution for infusion., CARBOPLATIN, INFLIXIMAB, PACLITAXEL, MYCOPHENOLATE MOFETIL, GEMCITABINE, Datopotamab deruxtecan, PACLITAXEL ALBUMIN-BOUND

Primary endpoint: PFS is defined as time from randomisation until progression per RECIST 1.1 as assessed by BICR, or death due to any cause., The comparison will include all randomised participants, as randomised, regardless of whether the participant withdraws from randomised therapy, receives another anticancer therapy or clinically progresses prior to RECIST 1.1 progression., However, if the participant progresses or dies immediately after 2 or more consecutive missed visits, the participant will be censored at the time of the latest evaluable assessment prior to the 2 missed visits. The measure of interest is the HR of PFS.
Endpoint(s): Overall Survival (OS): OS is defined as the time from the date of randomisation until death due to any cause., Objective Response Rate (ORR): Objective response rate is defined as the proportion of participants who have a CR or PR, as determined by the BICR/Investigator assessment, per RECIST 1.1., Duration of Response (DoR): Duration of response is defined as the time from the date of first documented response until date of documented progression per RECIST 1.1, as assessed by BICR/Investigator assessment or death due to any cause., Progression-Free Survival (PFS) by Investigator assessment: PFS by Investigator assessment will be defined as the time from the date of randomization until the date of PD per RECIST 1.1 by Investigator assessment or death due to any cause, Clinical benefit rate (CBR) at 24 weeks: is defined as the percentage of participants who have a CR or PR or who have SD, per RECIST 1.1, as assessed by BICR/per investigator assessment and derived from the raw tumour data for at least 23 weeks after randomisation., Clinical Outcome Assessments: The secondary PRO endpoints include: TTD in breast symptoms as measured by breast symptoms scale from EORTC IL116, TTD in arm symptoms as measured by arm symptoms scale from EORTC IL116, TTD in pain as measured by the pain scale from EORTC IL199, TTD in physical functioning as measured by the physical functioning scale from the PROMIS Short Form v2.0 – Physical Function 8c, TTD in GHS/QoL as measured by the GHS/QoL scale from EORTC IL172., Time to First Subsequent Therapy (TFST): Time to first subsequent therapy is defined as the time from randomization until the start date of the first subsequent anti-cancer therapy after discontinuation of randomized treatment, or death due to any cause., Time to Second Subsequent Therapy (TSST): Time to second subsequent therapy is defined as the time from randomization to until the start date of the second subsequent anti-cancer therapy after discontinuation of first subsequent treatment, or death due to any cause., Time from randomization to second progression or death (PFS2): Time to second progression of death will be defined as the time from the randomization to the earliest progression event (following the initial progression), subsequent to first subsequent therapy, or death. The date of second progression will be recorded by the Investigator in the eCRF and defined according to local standard clinical practice based on radiological or clinical progression., Pharmacokinetics of dato-DXd in combination with durvalumab, Immunogenicity of dato-DXd in combination with durvalumab, Safety & tolerability

Source: https://euclinicaltrials.eu/ctis-public/view/2023-503675-24-00